EU clinical trial 2022-502425-18-00: PEACE 6 Vulnerable : A double-blind randomised phase III trial evaluating the efficacy of ADT +/- darolutamide in de novo metastatic prostate cancer patients with vulnerable functional ability and not elected for docetaxel or androgen receptor targeted agents.
Protocol code: UC-GTG-2006
Sponsor: Unicancer (Hospital/Clinic/Other health care facility). Phase: Therapeutic confirmatory (Phase III). Countries: France (ongoing, recruiting), Spain (ongoing, recruiting), Ireland (ongoing, recruiting), Belgium (ongoing, recruiting), Italy (ongoing, recruiting), Romania (ongoing, recruiting), Sweden (authorised, recruiting), Netherlands (ongoing, recruiting), Slovakia (authorised, recruiting), Germany (ended).
Therapeutic area(s): Diseases [C] - Neoplasms [C04]
Gender: Male. Age: 18-64 years, 65+ years. Enrolment: 288.
Start date (EU): 2022-04-19. Decision date: 2023-05-12. Results received: No. Last updated: 2026-06-15.
Decision dates by country: DE: 2023-10-02, ES: 2023-05-17, RO: 2023-10-02, SE: 2023-09-25, SK: 2023-09-26, IE: 2023-05-12, BE: 2023-05-17, IT: 2023-09-26, FR: 2023-05-12, NL: 2023-10-02

Condition(s): Adenocarcinoma of the prostate
Product: BAY 1841788

Primary endpoint: Radiographic progression-free survival, defined as time from randomisation to radiographic progression as assessed by the investigator according to PCWG3 criteria (Scher, 2016; Appendix 3), or death, whichever occurs first.
Endpoint(s): Castration-resistant prostate cancer (CRPC)-free survival, defined as the time from randomisation to onset of CRPC according to PCWG3 criteria, or death, whichever occurs first., Clinical progression-free survival, defined as time from randomisation to first occurrence, Overall survival, defined as the time from randomisation to the time of death from any cause. For subjects alive at the time of analysis, data will be censored on the last date the subject was known to be alive or lost to follow-up or withdraw consent., Toxicity will be evaluated according to version 5 of the National Cancer Institut - Common Terminology Criteria for Adverse Events

Source: https://euclinicaltrials.eu/ctis-public/view/2022-502425-18-00